EU clinical trial 2024-514319-85-00: Phase II study on trabectedin in adults and young adults HEY1-NOCA2 positive skeletal and extra-skeletal mesenchymal chondrosarcoma (MCS)
Protocol code: ISG-MCS
Sponsor: Italian Sarcoma Group (Patient organisation/association). Phase: Therapeutic exploratory (Phase II). Countries: Italy (ongoing, recruiting).
Therapeutic area(s): Diseases [C] - Neoplasms [C04]
Gender: Female, Male. Age: 0-17 years, 18-64 years, 65+ years. Enrolment: 20.
Status: Ongoing, recruiting. Start date (EU): 2021-09-14. Decision date: 2024-07-02. Results received: No. Last updated: 2024-07-02.

Condition(s): Advanced rearranged mesenchymal chondrosarcoma
Product: Yondelis 1 mg powder for concentrate for solution for infusion., Yondelis 0.25 mg powder for concentrate for solution for infusion., Trabectedina Teva 0,25 mg polvere per concentrato per soluzione per infusione, Trabectedina Teva 1 mg polvere per concentrato per soluzione per infusione

Primary endpoint: Overall tumour Response Rate, according to RECIST v 1.1
Endpoint(s): Choi Response Rate, Overall Survival (OS), Progression Free Survival (PFS), Clinical Benefit Rate, Duration of response, Safety, Exploration of transcriptomic and genomic profile of responsive versus unresponsive tumors. Genomic, mRNA, miRNA expression pattern of a sizable number of responsive and unresponsive tumors will be analyzed and compared., Evaluation of efficacy of liquid biopsy (measure of HEY1-NCOA2 fusion in cell free DNA/RNA) in anticipating response/progression under treatment., Validazione dei target trascrizionali HEY1-NCOA2 coinvolti nella risposta MCS alla trabectedina mediante esperimenti in vitro.

Source: https://euclinicaltrials.eu/ctis-public/view/2024-514319-85-00